EU clinical trial 2024-517830-17-00: A Phase 2, Open-Label, Extension Study to Evaluate Long Term Safety and Clinical Activity of Briquilimab in Participants from Jasper-Sponsored Chronic Urticaria Trials
Protocol code: JSP-CP-014
Sponsor: Jasper Therapeutics Inc. (Pharmaceutical company). Phase: Therapeutic exploratory (Phase II). Countries: Germany (ended).
Therapeutic area(s): Diseases [C] - Skin and Connective Tissue Diseases [C17]; Diseases [C] - Immune System Diseases [C20]
Gender: Female, Male. Age: 18-64 years, 65+ years. Enrolment: 45.
Status: Ended. Start date (EU): 2025-03-14. End date (EU): 2026-07-21. Decision date: 2025-02-07. Results received: No. Last updated: 2025-12-22.

Condition(s): Chronic Urticaria
Product: Briquilimab

Primary endpoint: Incidence and severity of adverse events (AEs) including serious adverse events (SAEs), treatment-emergent adverse events (TEAEs) and adverse events of interest (AEIs). Physical examination findings and standard clinical laboratory parameters.
Endpoint(s): Chronic inducible urticaria {CIndU}: - Change from baseline in critical temperature threshold (CCT) and critical friction threshold (CFT) over time. - Change from Baseline in urticaria control test (UCT) over time. - Percentage of participants with complete response and well-controlled disease over time., Chronic spontaneous urticaria {CSU}: - Change from baseline in urticaria activity score over 7 days (UAS7), hive severity score over 7 days (HSS7), itch severity score over 7 days (ISS7), and uricaria control test (UCT) over time. - Percentage of participants with complete response and well-controlled disease over time.

Source: https://euclinicaltrials.eu/ctis-public/view/2024-517830-17-00